EU clinical trial 2024-513535-24-00: Spartalizumab and low-dose PAzopanib in Refractory or Relapsed solid TumOrs of pediatric and adults SPARTO
Protocol code: CHUBX 2020/31
Sponsor: Centre Hospitalier Universitaire De Bordeaux (Hospital/Clinic/Other health care facility). Phase: Phase I and Phase II (Integrated)- Other. Countries: France (temporarily halted).
Therapeutic area(s): Diseases [C] - Neoplasms [C04]
Gender: Female, Male. Age: 0-17 years, 18-64 years, 65+ years. Enrolment: 74.
Status: Temporarily halted. Start date (EU): 2022-05-02. Decision date: 2024-10-03. Results received: No. Last updated: 2025-11-21.

Condition(s): Refractory or Recurrent Solid Tumor
Product: Votrient 200 mg film-coated tablets, PDR001

Primary endpoint: For the pediatric cohort, the primary endpoint will be the Maximum Tolerated Dose (MTD). MTD will be defined as the dose closest to the target toxicity level of 25% of DLTs (Dose Limiting Toxicity) up to cycle 1 (4 weeks of treatment)., For the adult cohort, the primary efficacy endpoint will be the 6-month disease control rate, defined as the proportion of participants in complete response (CR), partial response (PR) or stable disease (SD) 6 months after treatment initiation. The subjects will be assigned a response category (CR, PR, SD or PD) according to RECIST 1.1 (Eisenhauer 2009) for solid tumor after every two treatment cycles.
Endpoint(s): Incidence of adverse events and serious adverse events, defined according to the NCI CTCAE v5.0 in all cycles of treatment., Overall Response Rate: The best overall response is the best response (CR or PR) recorded from the start of the treatment until patients get off-study or the cut-off date, whichever comes first (taking as reference for PD the smallest measurements recorded since the treatment started)., Progression-free survival, Overall survival, Response duration: will be measured from the time measurement criteria for CR/PR are first met until the first date that recurrent or progressive disease is objectively documented or death, whichever occurs earlier., Pazopanib pharmacocinetic parameters ( including but not limited to plasma concentration time profiles, AUClast, AUCtau, Cmin, Cmax, Tmax, Clearance, Half-life time) will be performed on D-7, D1 and D8 for cycle 1 and on D1 for cycles 2, 3, 6 and 12., Spartalizumab pharmacocinetic parameters ( including but not limited to plasma concentration time profiles, AUClast, AUCtau, Cmin, Cmax, Tmax, Clearance, Half-life time) will be performed on D1, D8 and D15 of cycle 1, on D1 and D15 of cycles 2, on D1 of cycles 3, 6 and 12., Pharmacodynamics parameters including angiogenic cytokines VEGF, soluble VEGFR-1, soluble VEGFR-2, endoglin (ENG), placental growth factor (PlGF) and Lymphocyte immunophenotyping including CD3, CD4, CD8, CXCR5, CXCR3, CCR6, PD1, ICOS, CD45Ra, OX40, CXCL13, IL6 will be obtained on D1 and D15 for cycle 1, on D1 for cycles 2, 3, 6 and 12., Identification of predictive biomarkers of immunotherapy based on genetic, immunological and metabolomic profiling of immune and tumor cells

Source: https://euclinicaltrials.eu/ctis-public/view/2024-513535-24-00